EU clinical trial 2024-512490-27-00: Early detection of hepatocellular carcinoma by Hyperpolarized [1- 13C]pyruvate MRI
Sponsor: Aarhus Universitet (Educational Institution). Phase: Therapeutic exploratory (Phase II). Countries: Denmark (ongoing, recruiting).
Therapeutic area(s): Analytical, Diagnostic and Therapeutic Techniques and Equipment [E] - Investigative Techniques [E05]
Gender: Female, Male. Age: 18-64 years, 65+ years. Enrolment: 46.
Status: Ongoing, recruiting. Start date (EU): 2023-06-19. Decision date: 2024-07-25. Results received: No. Last updated: 2024-07-25.

Condition(s): Primary liver cancer
Product: Hyperpolarized [1-13C]pyruvate

Primary endpoint: The raw data will be processed using both model-free and kinetic modeling approaches, which are the standards of analyzing hyperpolarized pyruvate MRI data, to quantify metabolism and perfusion.

Source: https://euclinicaltrials.eu/ctis-public/view/2024-512490-27-00